EU clinical trial 2023-506031-15-01: Hypertonic LActaTe afTer cardiac arrEst: the LATTE trial
Protocol code: SRB2021260
Sponsor: Hopital Erasme (Hospital/Clinic/Other health care facility). Phase: Therapeutic exploratory (Phase II). Countries: Belgium (ongoing, recruiting).
Therapeutic area(s): Diseases [C] - Nervous System Diseases [C10]; Diseases [C] - Cardiovascular Diseases [C14]
Gender: Female, Male. Age: 18-64 years, 65+ years. Enrolment: 125.
Status: Ongoing, recruiting. Start date (EU): 2025-02-18. Decision date: 2024-09-12. Results received: No. Last updated: 2026-02-23.

Condition(s): post-anoxic brain injury, Post cardiac arrest syndrome, Coma, Cardiac arrest
Product: Plasmalyte A Viaflo, solution pour perfusion, SODIO LATTATO MONICO 2 mEq/ml concentrato per soluzione per infusione

Primary endpoint: Neuron specific enolase (NSE) plasmatic peak values at 48 hours after return of spontaneous circulation.
Endpoint(s): Modified Rankin Scale at 90 days, ICU length of stay (days), Hospital length of stay (days)., Mortality during ICU stay, during hospital stay, at 90 days., Vasopressor equivalent dose during the first 48h after resuscitation., Seizures episodes during the first 24h, 48h and ICU stay., Peak plasmatic concentrations or neurofilament light chain (NFL) at 24, 48 and 72h., Peak plasmatic concentrations or glial fibrillary acid protein (GFAP) at 24, 48 and 72h, Peak plasmatic concentrations or Troponin I (TnI) at 24, 48 and 72h, Incidence, nature, and severity of adverse events graded according to National Cancer Institute - Common Terminology Criteria for Adverse Events.

Source: https://euclinicaltrials.eu/ctis-public/view/2023-506031-15-01